EU clinical trial 2023-508216-29-00: Prospective double-blind randomized comparative study of the use of methoxyflurane vs placebo in the management of pain in oral and dental emergencies in adults: METODO (METhoxyflurane in ODOntology)
Protocol code: 29BRC23.0024
Sponsor: Centre Hospitalier Regional Et Universitaire De Brest (Hospital/Clinic/Other health care facility). Phase: Therapeutic confirmatory (Phase III). Countries: France (ended).
Therapeutic area(s): Not possible to specify
Gender: Female, Male. Age: 18-64 years, 65+ years. Enrolment: 192.
Status: Ended. Start date (EU): 2024-10-14. End date (EU): 2025-10-03. Decision date: 2024-03-18. Results received: No. Last updated: 2024-03-18.

Condition(s): Dental care
Product: PENTHROX 3mL inhalation vapour, liquid, Placebo control corresponds to the same conditioning as the experimental treatment without methoxyflurane liquid bottle.

Primary endpoint: The primary endpoint was pain at baseline and at T=15min post-treatment, measured using a numerical pain scale (NPS) graded from 0 to 10
Endpoint(s): Pain intensity <4/10 (yes/no) at T=15min after treatment, Measurement of pain intensity at T=7min (immediate efficacy), Measurement of pain intensity at T=40 minutes after treatment and just prior to treatment by the practitioner (persistence of efficacy), Anxiety, measured at inclusion and just before chairside treatment using a translated and adapted anxiety questionnaire (MDAS: modified dental anxiety scale), Report adverse events in both groups, Measuring the amount of local anesthetic used during treatment, Post-care satisfaction questionnaire, Measurement of pain intensity at T=15min according to analgesic associated with methoxyflurane, Measurement of pain intensity at T=15min according to type of emergency

Source: https://euclinicaltrials.eu/ctis-public/view/2023-508216-29-00